EU clinical trial 2024-516409-22-00: DIABOUT - Extending time without diabetes after bariatric surgery: a randomized controlled trial comparing the metformin addition or not to standard care
Protocol code: P170901J
Sponsor: Assistance Publique Hopitaux De Paris (Hospital/Clinic/Other health care facility). Phase: Therapeutic confirmatory (Phase III). Countries: France (ongoing, recruitment ended).
Therapeutic area(s): Diseases [C] - Nutritional and Metabolic Diseases [C18]
Gender: Female, Male. Age: 18-64 years, 65+ years. Enrolment: 126.
Status: Ongoing, recruitment ended. Start date (EU): 2021-01-07. Decision date: 2024-08-14. Results received: No. Last updated: 2026-05-19.

Condition(s): Type 2 Diabetes complete remission after bariatric surgery under antidiabetic drug
Product: METFORMIN

Primary endpoint: Proportion of patients with partial or complete T2D remission criteria at three years in T2D patients operated of BS (GB or SG). Criteria for diabetes remission assessment will be used as described in 2012 in the American Diabetes Association guidelines (8,9): - Complete remission: HbA1c<5.7% and no anti-diabetic medication (except metformin in the experimental group). - Partial remission: HbA1c<6.5% and no anti-diabetic medication (except metformin in the experimental group).
Endpoint(s): Proportion of patients with T2D partial or complete remission criteria at 1 and 2 years, Proportion of patients with strict complete remission at 3 years, Percentage of weight and BMI change at 1,2 and 3 years compared to baseline, Level of cardio-metabolic parameters associated to T2D (fasting glycaemia and insulinemia, HOMA-IR, triglycerides and HDL cholesterol, blood pressure) at 1,2 and 3 years compared to baseline, Level of nutritional parameters associated with BS (albumin, hemoglobin, iron, serum ferritin, transferrin saturation, calcium, vitamins D and B1, B9, B12) at 1,2 and 3 years compared to baseline, Proportion of adverse drug reactions in the intervention group compared to standard care all along the trial (all visits), Adherence level in the intervention group as measured using pill counts (defined as taking at least 80% of assigned study pills in the intervention group) (all visits) and metformin plasmatic dosage at 1,2 and 3 years in sites that can perform it, Number and level of retinopathy, nephropathy and macroangiopathy events at 3 years, Quality of life changes assessed by EQ5D auto-questionnaire from baseline to 1, 2 and 3 years, 5y-Ad-Diarem score calculated with baseline data (inclusion) to assess clinical outcome at the end of the study, Changes in fecal microbiota (diversity, composition and function) from baseline at 1 and 3 years

Source: https://euclinicaltrials.eu/ctis-public/view/2024-516409-22-00